EU clinical trial 2023-504541-31-00: A Phase 3b, Open-label Study Evaluating the Efficacy and Safety of Luspatercept (BMS-986346/ACE-536) Initiated at Maximum Approved Dose in LR-MDS With IPSS-R Very Low-, Low-, or Intermediate-risk Who Require RBC Transfusions (MAXILUS)
Protocol code: CA0561060
Sponsor: Celgene Corp. (Pharmaceutical company). Phase: Therapeutic confirmatory (Phase III). Countries: Belgium (ongoing, recruitment ended), France (ongoing, recruitment ended), Italy (ongoing, recruitment ended), Spain (ongoing, recruitment ended), Poland (ongoing, recruitment ended), Czechia (ongoing, recruitment ended), Germany (ongoing, recruitment ended).
Therapeutic area(s): Diseases [C] - Congenital, Hereditary, and Neonatal Diseases and Abnormalities [C16]
Gender: Female, Male. Age: 18-64 years, 65+ years. Enrolment: 72.
Status: Ongoing, recruitment ended. Start date (EU): 2024-03-06. Decision date: 2024-02-13. Results received: No. Last updated: 2025-10-17.
Decision dates by country: ES: 2024-02-14, CZ: 2024-02-13, PL: 2024-02-16, BE: 2024-02-19, FR: 2024-02-14, IT: 2024-02-13, DE: 2024-03-01

Condition(s): Myelodysplastic syndrome
Product: Reblozyl 75 mg powder for solution for injection, Reblozyl 25 mg powder for solution for injection

Primary endpoint: composite of achievement of RBC-TI for 8-weeks with a concurrent mean Hb increase of ≥ 1 g/dL from Week 1 to Week 24.
Endpoint(s): Main secondary efficacy endpoints: mean change in total RBC units transfused over a fixed 16 week period from Week 9 to Week 24 and from Week 33 to Week 48. Time from first dose to first onset of RBC TI ≥ 8, 12, and 16 weeks, Maximum duration of RBC-TI for participants who achieve RBC TI ≥ 8- and 16-week period, Main secondary safety endpoint is the type, frequency, severity of AEs, and relationship of adverse events (AEs) to luspatercept from screening to 6 weeks (42-days) post last dose and from Week 1 to Week 48

Source: https://euclinicaltrials.eu/ctis-public/view/2023-504541-31-00